EU clinical trial 2024-519067-17-00: Prospective phase IIb study to evaluate the efficacy of laparoscopic electrochemotherapy in the treatment of locally advanced pancreatic cancer - ECT-LAPC Laparoscopic
Sponsor: IRCCS Istituto Nazionale Tumori Fondazione Pascale (Hospital/Clinic/Other health care facility). Phase: Therapeutic exploratory (Phase II). Countries: Italy (ongoing, recruiting).
Therapeutic area(s): Diseases [C] - Neoplasms [C04]
Gender: Female, Male. Age: 18-64 years, 65+ years. Enrolment: 90.
Status: Ongoing, recruiting. Start date (EU): 2024-12-02. Decision date: 2024-12-02. Results received: No. Last updated: 2024-12-02.

Condition(s): Locally Advanced Pancreatic Cancer
Product: BLEOPRIM 15 mg polvere per soluzione iniettabile, Fluorouracil 50 mg/ml Solution for Injection or Infusion, LEDERFOLIN 25 mg Polvere per soluzione iniettabile per uso endovenoso, CAMPTO 20 mg/mL concentrate for solution for infusion, Oxaliplatin 5 mg/ml Concentrate for Solution for infusion

Primary endpoint: Increase in the objective response rate of the treated lesion in the treatment arm compared to the control arm
Endpoint(s): Evaluate the effect of ECT on disease progression-free time and survival., Evaluate the impact of ECT on quality of life, with particular attention to its effect on pain, Assess the toxicity associated with Electrochemotherapy treatment., Evaluate the conversion rate of the disease from locally advanced to resectable between the two arms.

Source: https://euclinicaltrials.eu/ctis-public/view/2024-519067-17-00